EU clinical trial 2026-526581-24-01: Oral versus Intravenous Tranexamic Acid for Blood Loss Prevention in Off-Pump Coronary Artery Bypass Surgery: A Randomised Non-Inferiority Trial (TRANSCAB Study)
Sponsor: Sante et Prevoyance (Hospital/Clinic/Other health care facility). Phase: Therapeutic use (Phase IV). Countries: Belgium (authorised, recruitment pending).
Therapeutic area(s): Diseases [C] - Cardiovascular Diseases [C14]
Gender: Female, Male. Age: 18-64 years, 65+ years. Enrolment: 160.
Status: Authorised, recruitment pending. Decision date: 2026-07-06. Results received: No. Last updated: 2026-07-06.

Condition(s): Coronary artery disease requiring off-pump coronary artery bypass surgery (OPCAB)
Product: Tranexamic acid Tillomed 500 mg film-coated tablets, Tranexamic Acid 100 mg/ml Solution for Injection

Primary endpoint: Cumulative postoperative chest-tube drainage within 24 hours after surgery (mL).
Endpoint(s): Allogeneic red-blood-cell (RBC) transfusion (yes/no), Number of RBC units transfused, Calculated blood loss at 24 h (mL), Calculated blood loss at 48 h (mL), Intraoperative blood loss (mL), Chest-drain output at 12 h (mL), Time to chest-drain removal (hours), Postoperative haemoglobin at 24 h (g/dL), Nadir haemoglobin during index admission (g/dL), ICU length of stay (hours), Hospital length of stay (days), Re-exploration for bleeding within 48 h (yes/no), Thromboembolic events up to day 30 (composite: MI, ischaemic stroke/TIA, DVT, PE), Seizures up to day 30 (yes/no), Acute kidney injury (KDIGO) during index admission (any stage), All-cause mortality by day 30

Source: https://euclinicaltrials.eu/ctis-public/view/2026-526581-24-01